EU clinical trial 2024-520031-33-00: A Phase 2 Study to Evaluate the Safety, Tolerability, and Clinical Activity of BLU-808, a Wild Type KIT Inhibitor, in Chronic Inducible Urticaria and Chronic Spontaneous Urticaria
Protocol code: BLU-808-1201
Sponsor: Blueprint Medicines Corp. (Pharmaceutical company). Phase: Therapeutic exploratory (Phase II). Countries: Germany (ongoing, recruitment ended), Denmark (ongoing, recruitment ended), Spain (ongoing, recruitment ended), Italy (ongoing, recruitment ended).
Therapeutic area(s): Diseases [C] - Skin and Connective Tissue Diseases [C17]
Gender: Female, Male. Age: 18-64 years, 65+ years. Enrolment: 57.
Status: Ongoing, recruitment ended. Start date (EU): 2025-09-16. Decision date: 2025-08-27. Results received: No. Last updated: 2026-03-02.
Decision dates by country: ES: 2025-09-05, IT: 2025-09-02, DK: 2025-09-02, DE: 2025-08-27

Condition(s): Chronic Inducible Urticaria and Chronic Spontaneous Urticaria
Product: Placebo matching BLU-808, tablet, BLU-808, BLU-808

Primary endpoint: Part A/B: Overall safety profile as assessed by the type, frequency, severity, and causality of Adverse Events
Endpoint(s): 1. Part A: Cold-induced urticaria: mean change in critical temperature threshold using TempTest from Baseline to the end of Week 12, 2. Part A: Symptomatic dermographism: mean change in total Fric score using FricTest from Baseline to the end of Week 12, 3. Part A: Complete response rate at the end of Week 12, 4. Part B: Mean change from Baseline to the end of Week 12 in patient reported outcome(s), 5. Part B: Complete response rate at the end of Week 12, 6. Part A/B: Absolute and percent change in pharmacodynamic markers from Baseline to the end of Week 12, 7. Part A/B: Population pharmacokinetic parameters including but not limited to AUC, Cmax, Cmin, CL/F, Vc/F, and t1/2

Source: https://euclinicaltrials.eu/ctis-public/view/2024-520031-33-00